EU clinical trial 2025-522240-40-00: The POWER trial: A randomised, two-armed open label phase 3 clinical trial on personalised dose optimisation with adjuvant tamoxifen therapy after breast cancer to investigate the impact on discontinuation and efficacy compared to standard of care
Sponsor: Karolinska Institutet (Educational Institution). Phase: Therapeutic confirmatory (Phase III). Countries: Sweden (ongoing, recruiting).
Therapeutic area(s): Not possible to specify
Gender: Female. Age: 18-64 years, 65+ years. Enrolment: 1100.
Status: Ongoing, recruiting. Start date (EU): 2026-03-05. Decision date: 2025-09-02. Results received: No. Last updated: 2026-07-14.

Condition(s): Breast Cancer
Product: Tamoxifen Viatris 20 mg tabletter.

Primary endpoint: The primary endpoint is discontinuation of tamoxifen.
Endpoint(s): BESS plus (2007) scale and subscales and the POWER symptom questionnaire, Quality of life questionnaire, Concentration of circulating plasma metabolites, Invasive disease-free survival (iDSF), Distant relapse-free survival (DRFS), Breast cancer specific survival (BCSS), Overall survival (OS), Mammographic breast density, Cost effectiveness and use of health care resources, Genetic polymorphisms in germline DNA, Biomarkers used for therapeutic drug monitoring

Source: https://euclinicaltrials.eu/ctis-public/view/2025-522240-40-00